EU clinical trial 2023-503538-37-00: ASSESSMENT OF THE BRAIN DEPOSIT OF TAU 4R DETECTED BY BRAIN PET WITH 18F-PI2620 IN PROGRESSIVE SUPRANUCLEAR PALSY COMPARED TO CONTROLS WITHOUT NEURODEGENERATIVE TAUOPATHY 4R: A CLINICAL TRIAL
Protocol code: CUN-PETNeuroTau
Sponsor: University Clinic Of Navarra (Hospital/Clinic/Other health care facility). Phase: Therapeutic exploratory (Phase II). Countries: Spain (ongoing, recruitment ended).
Therapeutic area(s): Diseases [C] - Nervous System Diseases [C10]
Gender: Female, Male. Age: 18-64 years, 65+ years. Enrolment: 51.
Status: Ongoing, recruitment ended. Start date (EU): 2023-11-13. Decision date: 2023-08-07. Results received: No. Last updated: 2023-08-07.

Condition(s): Progressive supranuclear palsy
Product: [18F]PI-2620

Primary endpoint: Brain deposit of tau 4R protein by means of the PET-Tau imaging study using the 18F-PI2620 radiotracer
Endpoint(s): Pattern of glucose metabolism by PET-FDG, Motor (rigidity, bradykinesia, falls, dysarthria, etc.) and non-motor (depression, apathy, cognitive impairment) symptoms

Source: https://euclinicaltrials.eu/ctis-public/view/2023-503538-37-00